EU clinical trial 2024-520425-37-00: A Phase 1/2 Open-label, Multi-centre, Dose-exploration Trial to Evaluate the Safety and Preliminary Efficacy of VG801 via Subretinal Injection in Treatment of Patients with Biallelic ABCA4 Mutation-Associated Retinal Dystrophy.
Protocol code: VG801-2022A-EU-37-00
Sponsor: VeonGen Therapeutics GmbH (Pharmaceutical company). Phase: Phase I and Phase II (Integrated)- First administration to humans. Countries: Germany (authorised, recruitment pending).
Therapeutic area(s): Diseases [C] - Eye Diseases [C11]
Gender: Female, Male. Age: 0-17 years, 18-64 years. Enrolment: 6.
Status: Authorised, recruitment pending. Decision date: 2025-09-17. Results received: No. Last updated: 2026-07-02.

Condition(s): Biallelic ABCA4 Mutation-Associated Retinal Dystrophy.
Product: VG801

Primary endpoint: Safety Endpoint: Number of Adverse events (ocular and systemic), Safety Endpoint: Evaluation of the humoral immune responses against the AAV capsid, Safety Endpoint: Measurement of vector in blood, tears, and saliva (vector shedding) until two negative samples have been obtained, Safety Endpoint: Hematology, chemistry, and urinalysis, Safety Endpoint: Comprehensive ophthalmic assessments including slit lamp examination coupled with imaging including optical coherence tomography (OCT), fundus photography, intraocular pressure monitoring, and fundus autofluorescence imaging., Preliminary Efficacy Endpoint: Visual Function (BCVA, Pelli Robson contrast test, OCT, fundus photography, IOP, fundus autofluorescence imaging), Preliminary Efficacy Endpoint: Morphological retinal measures (Fundus autofluorescence imaging , Optical coherence tomography), Preliminary Efficacy EndPoint: Local retinal function measures for rods and cones ( Full-field stimulus threshold testing), Preliminary Efficacy Endpoint: Retinal function measures (Goldmann kinetic visual fields, Scotopic and photopic microperimetry), Preliminary Efficacy Endpoint: Mobility function (novel virtual reality mobility test)

Source: https://euclinicaltrials.eu/ctis-public/view/2024-520425-37-00